EU clinical trial 2024-516021-32-00: HORNbILL. HydrOcortisone and fludRocortisoNe for critical ILLness-related corticosteroid insufficiency
Protocol code: APHP200018
Sponsor: Assistance Publique Hopitaux De Paris (Hospital/Clinic/Other health care facility). Phase: Therapeutic confirmatory (Phase III). Countries: France (ended).
Therapeutic area(s): Not possible to specify
Gender: Female, Male. Age: 18-64 years, 65+ years. Enrolment: 3276.
Status: Ended. Start date (EU): 2022-02-17. End date (EU): 2025-11-09. Decision date: 2024-11-05. Results received: No. Last updated: 2024-11-05.

Condition(s): Critically ill patients suffering from CIRCI
Product: TETRACOSACTIDE, BETAMETHASONE, Placebo of fludrocortisone, Placebo of hydrocortisone hemisuccinate, FLUDROCORTISONE, HYDROCORTISONE HEMISUCCINATE

Primary endpoint: The primary end point is the number of ventilator- and vasopressor-free days up to day 30, defined as days from randomisation to 30 days thereafter, during which the patient is alive, free of mechanical ventilation, and free of treatment with intravenous vasopressors.
Endpoint(s): Mortality rates at ICU and hospital discharge and at day 30, 90 and 180 after randomization, Number of days alive without vasopressors on day 30 after randomization. Patients who die before vasopressor weaning will be considered as having 0 vasopressor free days., Number of days alive free of mechanical ventilation on day 30 after randomization. Patients who die before mechanical ventilation weaning will be considered as having 0 ventilator free days., Proportion of patients with a decision to withhold and/or withdraw active treatments, Renal replacement therapy (RRT)-free days up to Day 30 after randomisation (excluding patients on RRT for chronic renal failure at time of randomisation), Number of days alive with SOFA <4 in the 30 days after randomization, Number of 30-day intensive care unit (ICU)–free days, ICU and hospital length of stay, Rate of re-admission to the ICU during the 30 days after randomization, Score of cutaneous vasoconstrictor response to glucocorticoids (before administration of the corticoid treatment at study or placebo), Change in utility, based on the EuroQol group’s 5-dimension 5-level (EQ-5D-5L) questionnaire, up to Day 30 and 90 after randomisation, Safety endpoints, Secondary endpoint concerning non-randomised patients: - Ventilation and vasopressors free days at day 30 post SYNACTHENE® test and all cause 90 day mortality post SYNACTHENE® test (assessed using the same definition as for the primary endpoint: see section 4.1.1 of protocol) in subjects devoid of CIRCI.

Source: https://euclinicaltrials.eu/ctis-public/view/2024-516021-32-00